EU clinical trial 2023-507960-38-00: A randomized, single-blind trial to evaluate the safety and efficacy of apraglutide in subjects with Grade II to IV (MAGIC) steroid refractory gastrointestinal (GI) acute graft versus host disease on best available therapy.
Protocol code: TA799-101
Sponsor: VectivBio AG (Pharmaceutical company). Phase: Therapeutic exploratory (Phase II). Countries: Germany (ended).
Therapeutic area(s): Diseases [C] - Immune System Diseases [C20]
Gender: Female, Male. Age: 0-17 years, 18-64 years, 65+ years. Enrolment: 21.
Status: Ended. Start date (EU): 2022-06-01. End date (EU): 2024-12-17. End date: 2024-12-18. Decision date: 2024-05-03. Results received: Yes. Last updated: 2024-05-03.

Condition(s): Acute graft versus host disease (aGVHD)

Primary endpoint: 1. Adverse events (AEs; System Organ Class [SOC], frequency and severity)., 2. Incidence of AEs of special interest (AESIs) related to apraglutide: (injection site reactions, gastrointestinal obstructions, gallbladder, biliary and pancreatic disease, fluid overload, colorectal polyps, new malignancies, systemic hypersensitivity)., 3. Occurrence of clinically significant changes from baseline in clinical chemistry (including liver function tests), hematology, hemostasis, and urinalysis, 4. Occurrence of clinically significant changes from baseline in vital signs (blood pressure, heart rate)., 5. Occurrence of clinically significant changes from baseline in electrocardiogram (ECG) measurements (intervals and rhythm)., 6. Occurrence and titer of anti-drug antibodies (ADAs).
Endpoint(s): 1. Overall response rate (PR and CR) at Day 56 on the lower GI tract MAGIC score., 2. Overall response rate (PR and CR) at Days 14, 28, 91, 119, 147, and 182 on the lower GI tract MAGIC score., 3. Overall response rate (PR and CR) at Days 14, 28, 56, 91, 119, 147, and 182 by organ system (skin, lower and upper GI tract and liver) on the total MAGIC score., 4. Proportion of all subjects who achieve a CR or PR at Day 28 and maintain a CR or PR at Day 56., 5. Duration of response from Day 56 (median and range) on the total MAGIC score where duration of response is defined as the interval from the Day 56 response (PR and CR) to death or new systemic therapy for aGVHD (including an increase in steroids >2 mg/kg/day methylprednisolone [MP] equivalent), whichever occurs first, with at least 182 days of follow-up., 6. Duration of response from Day 28 (median and range) on the total MAGIC score where duration of response is defined as the interval from the Day 28 response (PR and CR) to death or new systemic therapy for aGVHD (including an increase in steroids >2 mg/kg/day MP equivalent), whichever occurs first, with at least 182 days of follow-up., 7. Individual duration of lower GI response (according to the MAGIC score) counted from the first response to return to baseline or worse., 8. Individual duration of lower GI response (according to the MAGIC score) in subjects that were re-treated with apraglutide because of a lower GI-aGVHD flare, counted from the first response after apraglutide restart to return to baseline or worse., 9. Time to partial lower GI-aGVHD response (median and range) as defined by the MAGIC score., 10. Time to complete lower GI-aGVHD response (median and range) as defined by the MAGIC score., 11. Best overall response defined as overall response (PR or CR) at any time point up to and including Day 91 and before the start of additional systemic therapy for lower GI-aGVHD., 12. Failure free survival up to 2 years post-first dose of apraglutide., 13. Non relapse mortality up to 2 years post-first dose of apraglutide., 14. Incidence of malignancy relapse up to 2 years post-first dose of apraglutide., 15. Overall survival up to 2 years post-first dose of apraglutide., 16. Graft failure up to 2 years post-first dose of apraglutide., 17. Incidence of lower GI-aGVHD flare up to Day 182 after first apraglutide dose following earlier cessation due to complete lower GIaGVHD response., 18. Cumulative SS and RUX doses from start of the RUX treatment up to Day 91 after the first dose of apraglutide., 19. Incidence of infections and sepsis from baseline up to Day 91 after first dose of apraglutide., 20. Effect of the two dose groups on safety/tolerability and efficacy.

Source: https://euclinicaltrials.eu/ctis-public/view/2023-507960-38-00